EU clinical trial 2024-515462-14-00: Prospective evaluation of potential effects of repeated gadolinium-based contrast agent (GBCA) administrations of the same GBCA on motor and cognitive functions in neurologically normal adults in comparison to a non-GBCA exposed control group—ODYSSEY
Protocol code: IQVIA-ODYS-001-LZA45
Sponsor: Iqvia Rds France (Pharmaceutical company). Phase: Therapeutic use (Phase IV). Countries: Italy (authorised, recruitment pending), Germany (authorised, recruitment pending), France (authorised, recruitment pending).
Therapeutic area(s): Analytical, Diagnostic and Therapeutic Techniques and Equipment [E] - Diagnosis [E01]
Gender: Female, Male. Age: 18-64 years. Enrolment: 717.
Status: Authorised, recruitment pending. Decision date: 2024-11-27. Results received: No. Last updated: 2026-04-20.
Decision dates by country: IT: 2025-01-10, DE: 2024-11-28, FR: 2024-11-27

Condition(s): Long term potential effect of repeated exposure to either a linear or a macrocyclic gadolinium-based contrast agent (GBCA) on change from baseline to Year 5 in motor and cognitive function among neurologically normal adults in comparison to a matched non-GBCA–exposed control group effects regarding.
Product: GADOBENATE DIMEGLUMINE, GADOBUTROL, GADOBENATE DIMEGLUMINE, GADOBUTROL, GADOBENATE DIMEGLUMINE, GADOBUTROL, GADOTERIC ACID, GADOTERIDOL, GADOBUTROL, GADOBUTROL, GADOTERIDOL, GADOXETIC ACID, DISODIUM, GADOBUTROL, GADOTERIDOL, GADOBENATE DIMEGLUMINE, GADOTERIC ACID, GADOTERIDOL, GADOTERIDOL, GADOXETIC ACID, DISODIUM, GADOTERIDOL, GADOBENATE DIMEGLUMINE, GADOBENATE DIMEGLUMINE, GADOXETIC ACID, DISODIUM, GADOTERIDOL, GADOTERIDOL, GADOBENATE DIMEGLUMINE

Primary endpoint: The co-primary endpoints are the change from baseline to Year 5 in motor function and in cognitive function as expressed by the composite z score, defined as the weighted sum of the z scores of the individual tests. Since each of these tests is considered equally important, each test will be assigned an equal weight.
Endpoint(s): Changes from baseline in the composite endpoint (Years 1 to 4) and in each individual test of motor and cognitive function (Years 1 to 5) will be assessed., Evaluation of AEs. The recording of AEs that occur after signing of the informed consent form (ICF) at Screening, will be done at baseline and at each annual visit. Signs/symptoms, onset date/time, severity, causality, seriousness, treatment and outcome will be recorded., Total gadolinium concentrations in blood plasma and urine samples collected at baseline and at each annual visit will be determined. If the CE-MRI is obtained at the same visit, the blood and urine samples will be obtained prior to imaging.

Source: https://euclinicaltrials.eu/ctis-public/view/2024-515462-14-00